EU clinical trial 2023-510472-31-00: A study in healthy volunteers to find out how long aticaprant stays in and acts on the body when administered with or without food and with or without fluconazole
Protocol code: 67953964MDD1010
Sponsor: Janssen Cilag International (Pharmaceutical company). Phase: Human Pharmacology (Phase I)- Other. Countries: Belgium (ended).
Therapeutic area(s): Psychiatry and Psychology [F] - Mental Disorders [F03]
Gender: Female, Male. Age: 18-64 years. Enrolment: 18.
Status: Ended. Start date (EU): 2024-07-05. End date (EU): 2024-09-16. Decision date: 2024-05-27. Results received: No. Last updated: 2024-05-27.

Condition(s): Healthy Adult Participants

Source: https://euclinicaltrials.eu/ctis-public/view/2023-510472-31-00